EU clinical trial 2023-506551-23-00: A PHASE 3, RANDOMIZED, DOUBLE-BLIND, MULTICENTER STUDY OF DOSTARLIMAB (TSR-042) PLUS CARBOPLATIN-PACLITAXEL VERSUS PLACEBO PLUS CARBOPLATIN-PACLITAXEL IN PATIENTS WITH RECURRENT OR PRIMARY ADVANCED ENDOMETRIAL CANCER (RUBY)
Protocol code: 4010-03-001
Sponsor: Tesaro Inc. (Pharmaceutical company). Phase: Therapeutic confirmatory (Phase III). Countries: Belgium (ongoing, recruitment ended), Poland (ended), Spain (ended), Hungary (ongoing, recruitment ended), Norway (ongoing, recruitment ended), Germany (ongoing, recruitment ended), Finland (ongoing, recruitment ended), Netherlands (ongoing, recruitment ended), Denmark (ongoing, recruitment ended), Greece (ended), Sweden (ongoing, recruitment ended), Italy (ongoing, recruitment ended), Czechia (ongoing, recruitment ended).
Therapeutic area(s): Diseases [C] - Female Urogenital Diseases and Pregnancy Complications [C13]
Gender: Female. Age: 18-64 years, 65+ years. Enrolment: 225.
Start date (EU): 2019-11-21. Decision date: 2024-07-12. Results received: No. Last updated: 2026-05-21.
Decision dates by country: GR: 2024-07-22, NO: 2024-07-15, SE: 2024-07-16, HU: 2024-07-16, BE: 2024-07-15, PL: 2024-07-15, ES: 2024-07-12, IT: 2024-07-17, FI: 2024-07-17, CZ: 2024-07-15, DK: 2024-07-16, NL: 2024-07-15, DE: 2024-07-15

Condition(s): Recurrent or primary advanced (Stage III or IV) endometrial cancer
Product: Niraparib Placebo Capsules, Niraparib Placebo Tablets, G5W (5% glucose in water), JEMPERLI 500 mg concentrate for solution for infusion

Primary endpoint: Primary Endpoints for Part 1: The primary efficacy endpoint of PFS is based on the investigator assessment, which is defined as the time from the date of randomization to the earliest date of radiographic assessment of PD or death by any cause in the absence of PD, whichever occurs first. Tumor response will be evaluated using RECIST v.1.1., Primary Endpoints for Part 1: The primary efficacy endpoint of overall survival is defined as the time from randomization to the date of death by any cause., Primary Endpoint for Part 2: The primary efficacy endpoint of PFS is based on the investigator assessment, which is defined as the time from the date of randomization to the earliest date of radiographic assessment of PD or death by any cause in the absence of PD, whichever occurs first. Tumor response will be evaluated using RECIST v.1.1.
Endpoint(s): 1. OS, defined as the time from randomization to the date of death by any cause (Part 2 only)., 2. PFS based on BICR assessment, defined as the time from randomization to the earliest date of assessment of PD per RECIST v.1.1 or death by any cause in the absence of PD per RECIST v.1.1, whichever occurs first, 3. ORR based on BICR and Investigator assessment, defined as the proportion of subjects with a best overall response (BOR) of complete response (CR) or partial response (PR), 4. DOR based on BICR and Investigator assessment, defined as the time from the first documentation of CR or PR until the time of the first documentation of subsequent PD per RECIST v.1.1 or death by any cause in the absence of PD per RECIST v.1.1, whichever occurs first, 5. DCR based on BICR and Investigator assessment, defined as the proportion of subjects who have achieved a BOR of CR, PR, or stable disease per RECIST v.1.1, 6. PFS2, defined as the time from treatment randomization to the date of assessment of progression on the first subsequent anticancer therapy following study treatment or death by any cause, whichever is earlier, 7. PRO assessment of treatment using EQ-5D-5L, EORTC QLQ-C30, and EORTC QLQ EN24, 8. PK and immunogenicity of dostarlimab (Part 1 and Part 2) and PK of niraparib when administered in combination with dostarlimab (Part 2 only)

Source: https://euclinicaltrials.eu/ctis-public/view/2023-506551-23-00